EU clinical trial 2024-518653-41-00: RANDOMIZED, CONTROLLED, OPEN TRIAL OF TWO STANDARDIZED DECLINE SCHEMES, FAST (NORTH AMERICAN) AND SLOW (EUROPEAN) RESPECTIVELY, OF CORTISONE IN GIANT CELL ARTERITIS
Protocol code: 17-249
Sponsor: Centre Hospitalier Universitaire De Caen Normandie (Hospital/Clinic/Other health care facility). Phase: Therapeutic confirmatory (Phase III). Countries: France (authorised, recruitment pending).
Therapeutic area(s): Diseases [C] - Cardiovascular Diseases [C14]
Gender: Female, Male. Age: 18-64 years, 65+ years. Enrolment: 150.
Status: Authorised, recruitment pending. Decision date: 2024-11-19. Results received: No. Last updated: 2025-07-24.

Condition(s): Patients with giant cell arteritis (= Horton’s disease)
Product: PREDNISONE VIATRIS 5 mg, comprimé sécable, PREDNISONE VIATRIS 20 mg, comprimé sécable, PREDNISONE VIATRIS 1 mg, comprimé

Primary endpoint: In each of the two arms (28- and 52-week regimens): number of patients in complete remission without relapse at S52, based on total number of patients included
Endpoint(s): - Measurement of the number of 1st relapses at S28 and S52 / number of patients included - Measurement of the number of 2nd relapses at S28 and S52 / number of patients included, - Measurement of extremes, means and medians of time to 1st and 2nd relapses, - Measurement of extremes, means, and medians of durations and individual cumulative doses of cortisone relative to body weights at S28 and S52, - Measuring the number of patients with cortico-dependent disease at S52, measurement of blood pressure, weight, glycemia, glycated hemoglobin, biochemistry, infectious complications, fracture complications, glaucoma, cataracts. Screening in both arms for the onset or decompensation of type 2 diabetes and any cardiovascular events. Bone densitometry (at baseline, S28 and S52) and adverse events attributable to corticosteroid therapy as soon as consent was signed and for the duration of the study.

Source: https://euclinicaltrials.eu/ctis-public/view/2024-518653-41-00